EU clinical trial 2024-515400-40-00: IMpact of Phenylephrine vs. norAdrenaline on systemic hemodynamics and Cerebral Tissue circulation and oxygenation in anesthetized brain tumor patients (IMPACT)
Sponsor: Region Midtjylland (Hospital/Clinic/Other health care facility). Phase: Phase III and phase IV (Integrated). Countries: Denmark (ongoing, recruiting).
Therapeutic area(s): Analytical, Diagnostic and Therapeutic Techniques and Equipment [E] - Anesthesia and Analgesia [E03]
Gender: Female, Male. Age: 18-64 years, 65+ years. Enrolment: 32.
Status: Ongoing, recruiting. Start date (EU): 2024-07-04. Decision date: 2024-07-04. Results received: No. Last updated: 2025-11-24.

Condition(s): low blood pressure during anesthesia
Product: NORADRENALINE TARTRATE, PHENYLEPHRINE

Primary endpoint: The primary endpoint is the between-group difference in ΔCBF (Δ= posttreatment value-pretreatment value).

Source: https://euclinicaltrials.eu/ctis-public/view/2024-515400-40-00